EU clinical trial 2025-523899-23-00: A study in healthy men to test how well different doses of BI 3821001 are tolerated
Protocol code: 2007-0001
Sponsor: Boehringer Ingelheim International GmbH (Pharmaceutical company). Phase: Human Pharmacology (Phase I)- First administration to humans. Countries: Germany (ongoing, recruiting).
Therapeutic area(s): Not possible to specify
Gender: Male. Age: 18-64 years. Enrolment: 72.
Status: Ongoing, recruiting. Start date (EU): 2026-04-15. Decision date: 2026-03-18. Results received: No. Last updated: 2026-07-08.

Condition(s): Healthy volunteer trial

Source: https://euclinicaltrials.eu/ctis-public/view/2025-523899-23-00